EU clinical trial 2024-519699-24-00: An open-label, uncontrolled, multicenter study to assess the effect of zigakibart treatment on histologic, circulating, and excreted markers of kidney disease and dysfunction in adult patients with IgA nephropathy
Protocol code: CFUB523A12201
Sponsor: Novartis Pharma AG (Pharmaceutical company). Phase: Therapeutic exploratory (Phase II). Countries: Czechia (authorised, recruitment pending), Germany (ongoing, recruiting), Spain (ongoing, recruiting), Italy (ongoing, recruiting), Poland (authorised, recruitment pending).
Therapeutic area(s): Diseases [C] - Immune System Diseases [C20]
Gender: Female, Male. Age: 18-64 years, 65+ years. Enrolment: 15.
Start date (EU): 2026-04-23. Decision date: 2026-03-17. Results received: No. Last updated: 2026-03-23.
Decision dates by country: CZ: 2026-03-17, DE: 2026-03-18, IT: 2026-03-20, ES: 2026-03-18, PL: 2026-03-23

Condition(s): IgA nephropathy
Product: Bion 1301/FUB523

Primary endpoint: Change in the level of IgA deposition in kidney tissue after 1 or 2 years of zigakibart treatment, compared to before treatment.
Endpoint(s): Clinical/laboratory assessments and adverse events., Impact on immune response to vaccination, during the period of 6 to 23 months after the first treatment., Kidney biopsy measures: changes in MEST- C score (an established measure of IgAN severity) and CD68 and C3c (inflammation markers), after 1 or 2 years of zigakibart treatment compared to before treatment., Kidney function tests: urine protein and blood presence and estimated glomerular filtration rate (a blood test assessing kidney’s filtering function), at multiple timepoints during the 2- year zigakibart treatment compared to before treatment., IgAN markers in blood: Immunoglobulin levels (IgA, IgM, IgG) at multiple timepoints during the 2-year zigakibart treatment compared to before treatment., Zigakibart concentrations in blood at multiple timepoints during the 2-year treatment., Presence of antibodies against zigakibart in blood before and at multiple timepoints during the 2-year zigakibart treatment.

Source: https://euclinicaltrials.eu/ctis-public/view/2024-519699-24-00